EU clinical trial 2023-509482-20-00: A Phase II, Open-label Study to Evaluate the Safety, Tolerability, Pharmacokinetics, Immunogenicity, and Antitumor Activity of Volrustomig Priming Regimens in Combination with Other Anticancer Agents in Participants with Solid Tumors (eVOLVE 01). Substudy 1: Volrustomig + Chemotherapy as 1L Treatment in Participants with Advanced or Metastatic NSCLC NSQ and PD-L1 TPS xx; Substudy 2: Volrustomig + Ramucirumab + Chemotherapy as 1L Treatment in Participants with Advanced or Metastatic NSCLC SQ or NSQ and PD-L1 TPS xx
Protocol code: D798KC00001
Sponsor: AstraZeneca AB (Pharmaceutical company). Phase: Therapeutic exploratory (Phase II). Countries: Italy (ongoing, recruiting), Portugal (ongoing, recruiting), Spain (ongoing, recruiting), France (ongoing, recruiting), Greece (ongoing, recruiting), Romania (ongoing, recruiting).
Therapeutic area(s): Diseases [C] - Neoplasms [C04]
Gender: Female, Male. Age: 18-64 years, 65+ years. Enrolment: 91.
Status: Ongoing, recruiting. Start date (EU): 2024-12-03. Decision date: 2024-10-24. Results received: No. Last updated: 2026-03-31.
Decision dates by country: PT: 2024-10-28, FR: 2024-10-28, RO: 2025-06-30, IT: 2024-10-28, ES: 2024-10-24, GR: 2025-05-16

Condition(s): Solid Tumors, SQ, NSQ NSCLC
Product: Carboplatin Hikma 10 mg/ml Konzentrat zur Herstellung einer Infusionslösung, Pemetrexed Accord 25 mg/ml concentrate for solution for infusion, Paclitaxel Bendalis 6 mg/ml Konzentrat zur Herstellung einer Infusionslösung, Mycofit, 250 mg, kapsułki twarde, Remsima 100 mg powder for concentrate for solution for infusion, volrustomig, Cyramza 10 mg/ml concentrate for solution for infusion

Primary endpoint: The safety and tolerability of volrustomig in combination with other anticancer drugs in participants with specified solid tumors will be assessed., ORR is defined as the percentage of participants who have a confirmed complete response (CR) or confirmed partial response (PR), as per Response Evaluation Criteria in Solid Tumors, Version 1.1 (RECIST 1.1).
Endpoint(s): DOR is defined as the time from the date of first documented response until the date of documented progression or death due to any cause (in the absence of progression)., PFS is defined as the time from randomization or first dose until radiological progression or death due to any cause (in the absence of progression)., OS is defined as the time from randomization or first dose until the date of death due to any cause., The serum concentrations volrustomig alone and when used in combination with other anticancer agents in participants with pre-specified solid tumors will be assessed., The trough concentrations volrustomig alone and when used in combination with other anticancer agents in participants with pre-specified solid tumors will be assessed., The AUC concentrations of volrustomig alone and when used in combination with other anticancer agents in participants with pre-specified solid tumors will be assessed., The incidence of ADAs against volrustomig or other anticancer agents in serum will be assessed., DCR is defined as the percentage of participants who have a CR or PR or who have stable disease (SD) after the date of randomization or first dose.

Source: https://euclinicaltrials.eu/ctis-public/view/2023-509482-20-00